EU clinical trial 2022-502051-56-00: ONC201 for the Treatment of Newly Diagnosed H3 K27M-mutant Diffuse Glioma Following Completion of Radiotherapy: A Randomized, Double-Blind, Placebo-Controlled, Multicenter Study (The ACTION Study)
Protocol code: ONC201-108
Sponsor: Chimerix Inc. (Pharmaceutical company). Phase: Therapeutic confirmatory (Phase III). Countries: Netherlands (ongoing, recruiting), Germany (ongoing, recruiting), Italy (ongoing, recruiting), Spain (ongoing, recruiting), Denmark (ongoing, recruiting), Austria (ongoing, recruiting).
Therapeutic area(s): Diseases [C] - Neoplasms [C04]
Gender: Female, Male. Age: 0-17 years, 18-64 years, 65+ years. Enrolment: 170.
Status: Ongoing, recruiting. Start date (EU): 2023-04-28. Decision date: 2023-04-18. Results received: No. Last updated: 2026-06-08.
Decision dates by country: IT: 2023-04-20, ES: 2023-04-24, DE: 2023-04-24, AT: 2024-01-15, DK: 2023-04-18, NL: 2023-04-18

Condition(s): H3 K27M-mutant diffuse glioma
Product: Placebo for ONC201

Primary endpoint: Overall survival
Endpoint(s): • Incidence of AEs: overall, treatment-related, Grade 3 or higher in severity, serious, fatal, those resulting in treatment discontinuation, and events of special interest • Change from baseline in clinical laboratory parameters • Distribution of graded clinical laboratory parameters, • PFS using RANO 2.0 criteria for all participants * PFS using RANO-HGG criteria for participants with measurable contrast-enhancing disease, • Corticosteroid response • Time to first corticosteroid response • Duration of first corticosteroid response • Cumulative duration of corticosteroid responses • Corticosteroid dose and change from baseline over time • Time to corticosteroid use deterioration, • Performance status response • Time to first performance status response • Duration of first performance status response • Cumulative duration of performance status responses • Performance status and change from baseline over time • Time to performance status deterioration, • Change from baseline in QoL assessments o ≥ 18 years of age: EORTC-QLQ-C30, QLQ-BN20, and MDASI-BT o 2 to < 18 years of age: PedsQL Brain Tumor Module • Change from baseline in Neurologic Assessment in Neuro-Oncology (NANO) score

Source: https://euclinicaltrials.eu/ctis-public/view/2022-502051-56-00